EU clinical trial 2025-525085-29-00: A first study in healthy volunteers to examine the safety and tolerability of convalescent plasma given through the nose, as well as the duration of its presence in the nose
Protocol code: ICONIC
Sponsor: Rode Kruis-Vlaanderen (Hospital/Clinic/Other health care facility). Phase: Human Pharmacology (Phase I)- First administration to humans. Countries: Belgium (authorised, recruitment pending).
Therapeutic area(s): Diseases [C] - Virus Diseases [C02]; Diseases [C] - Respiratory Tract Diseases [C08]
Gender: Female, Male. Age: 18-64 years. Enrolment: 104.
Status: Authorised, recruitment pending. Decision date: 2026-06-18. Results received: No. Last updated: 2026-06-18.

Condition(s): Healthy volunteers

Source: https://euclinicaltrials.eu/ctis-public/view/2025-525085-29-00